EU clinical trial 2025-523758-15-00: A Phase 1/2, multicentre, open-label clinical trial of DT-7012 as monotherapy and in combination with an immune checkpoint inhibitor in participants with selected advanced solid tumours
Protocol code: DT-7012-CLI-001
Sponsor: Domain Therapeutics Australia Pty Limited (Pharmaceutical company). Phase: Phase I and Phase II (Integrated)- First administration to humans. Countries: France (ongoing, recruiting).
Therapeutic area(s): Diseases [C] - Neoplasms [C04]
Gender: Female, Male. Age: 18-64 years, 65+ years. Enrolment: 18.
Status: Ongoing, recruiting. Start date (EU): 2026-02-11. Decision date: 2026-01-14. Results received: No. Last updated: 2026-02-05.

Condition(s): Cancer

Primary endpoint: Occurrence of dose-limiting toxicities (DLTs) during the DLT observation period and occurrence of treatment-emergent adverse events (TEAEs), treatment-related adverse events (TRAEs), adverse events of special interest (AESIs), serious advers events (SAEs) and adverse events (AEs) leading to treatment discontinuation.
Endpoint(s): Occurrence of DLTs, TEAEs, TRAEs, AESIs, SAEs, and AEs leading to treatment discontinuation., Measurement of pharmacokinetics parameters: maximum (peak) observed plasma concentration [Cmax] and time of maximum (peak) observed plasma concentration [Tmax]., Measurement of anti-tumour activity parameters: overall response rate (ORR), disease control rate (DCR), duration of response (DOR), duration of stable disease (SD).

Source: https://euclinicaltrials.eu/ctis-public/view/2025-523758-15-00